EU clinical trial 2023-507451-30-00: Vitiligo treatment by targeting TYK2 mediated responses
Protocol code: 23-PP-08
Sponsor: Centre Hospitalier Universitaire De Nice (Hospital/Clinic/Other health care facility). Phase: Therapeutic exploratory (Phase II). Countries: France (ongoing, recruitment ended).
Therapeutic area(s): Diseases [C] - Skin and Connective Tissue Diseases [C17]
Gender: Female, Male. Age: 18-64 years, 65+ years. Enrolment: 140.
Status: Ongoing, recruitment ended. Start date (EU): 2024-04-02. Decision date: 2024-03-08. Results received: No. Last updated: 2026-08-03.
Decision dates by country: FR: 2024-03-29

Condition(s): Vitiligo

Source: https://euclinicaltrials.eu/ctis-public/view/2023-507451-30-00